EU clinical trial 2024-511222-30-00: A Phase 2a, Randomized, Double-blind, Placebo-controlled Trial to Evaluate the Safety, Tolerability, and Pharmacokinetics of Multiple Ascending Dosing of Exidavnemab in Patients with Mild to Moderate Parkinson’s Disease on Stable Symptomatic Parkinson’s Disease Medication and in Patients with Multiple System Atrophy
Protocol code: BAN0805-201
Sponsor: BioArctic AB (Pharmaceutical company). Phase: Therapeutic exploratory (Phase II). Countries: Spain (ongoing, recruitment ended), Poland (ongoing, recruitment ended).
Therapeutic area(s): Diseases [C] - Nervous System Diseases [C10]
Gender: Female, Male. Age: 18-64 years, 65+ years. Enrolment: 36.
Status: Ongoing, recruitment ended. Start date (EU): 2024-10-22. Decision date: 2024-09-23. Results received: No. Last updated: 2026-07-31.
Decision dates by country: PL: 2024-09-30, ES: 2024-09-23

Condition(s): Parkinson’s Disease (PD), Multiple System Atrophy
Product: Exidavnemab, nothing (blank / empty saline solution)

Primary endpoint: To determine the occurrence of AEs and SAEs after 4 treatment cycles by assessing the frequency, severity, causality, and nature of AEs and SAEs; also changes in ECG, vital signs (arterial blood pressure, heart rate, and temperature), and laboratory tests (hematology, serum chemistry, and urine) will be assessed for tolerability. The severity of the AEs and SAEs will be determined by CTCAE v5.0.
Endpoint(s): The recommended maximal dose will be defined by the safety and tolerability profile and PK data., Exposure levels of exidavnemab in serum (i.e., PK parameters of exidavnemab)., Immunogenicity; determination of ADAs in serum by using a tier-based approach followed by determination of NAbs if relevant.

Source: https://euclinicaltrials.eu/ctis-public/view/2024-511222-30-00